EU clinical trial 2023-507599-34-00: Randomised, relative bioavailability clinical trial of amylmetacresol, dichlorobenzyl alcohol, lidocaine and vitamin c lozenges after a single oral dose administration to healthy volunteers under fasting conditions in a crossover design.
Protocol code: G23-00
Sponsor: Geiser Pharma S.L. (Pharmaceutical company). Phase: Human Pharmacology (Phase I)- Bioequivalence Study. Countries: Spain (ended).
Therapeutic area(s): Diseases [C] - Respiratory Tract Diseases [C08]
Gender: Female, Male. Age: 18-64 years. Enrolment: 60.
Status: Ended. Start date (EU): 2024-03-11. End date (EU): 2024-04-15. Decision date: 2023-12-04. Results received: No. Last updated: 2024-03-01.

Condition(s): healthy volunteer

Source: https://euclinicaltrials.eu/ctis-public/view/2023-507599-34-00